EU clinical trial 2024-511205-33-00: Study of U3-1402 in subjects with non-small cell lung cancer
Protocol code: U31402-A-U102
Sponsor: Daiichi Sankyo Inc. (Pharmaceutical company). Phase: Human Pharmacology (Phase I)- Other. Countries: Spain (ongoing, recruitment ended), Netherlands (ongoing, recruitment ended).
Therapeutic area(s): Diseases [C] - Neoplasms [C04]
Gender: Female, Male. Age: 18-64 years, 65+ years. Enrolment: 28.
Status: Ongoing, recruitment ended. Start date (EU): 2020-05-18. Decision date: 2024-08-15. Results received: No. Last updated: 2026-04-17.
Decision dates by country: NL: 2024-08-15, ES: 2024-09-03

Condition(s): METASTATIC OR UNRESECTABLE NON-SMALL CELL LUNG CANCER

Source: https://euclinicaltrials.eu/ctis-public/view/2024-511205-33-00